EU clinical trial 2024-518557-42-00: Endocrine, Cardiovascular, Pharmacological, and Physiological Aspects of Sex Hormone Therapy in Turner Syndrome - Study 1
Sponsor: Region Midtjylland (Hospital/Clinic/Other health care facility). Phase: Therapeutic use (Phase IV). Countries: Denmark (ongoing, recruiting).
Therapeutic area(s): Diseases [C] - Hormonal diseases [C19]
Gender: Female. Age: 18-64 years. Enrolment: 50.
Status: Ongoing, recruiting. Start date (EU): 2021-11-29. Decision date: 2024-10-23. Results received: No. Last updated: 2024-10-23.

Condition(s): Turner syndrome
Product: Estrofem, filmovertrukne tabletter, Divigel 1 mg gel

Primary endpoint: Equipotency: Levels of luthenizing hormone and follicle stimulating hormone are measured at different doses

Source: https://euclinicaltrials.eu/ctis-public/view/2024-518557-42-00